EU clinical trial 2025-521290-14-00: Immediate post-surgical Botulinum toxin injections to prevent dystrophic Scars after sternotomy : a placebo-controlled randomized clinical trial - BotuCiSter
Sponsor: Centre Hospitalier Universitaire De Bordeaux (Hospital/Clinic/Other health care facility). Phase: Therapeutic confirmatory (Phase III). Countries: France (authorised, recruitment pending).
Therapeutic area(s): Diseases [C] - Skin and Connective Tissue Diseases [C17]
Gender: Female, Male. Age: 18-64 years, 65+ years. Enrolment: 50.
Status: Authorised, recruitment pending. Decision date: 2025-08-06. Results received: No. Last updated: 2025-08-06.

Condition(s): Surgery with sternotomy
Product: SODIUM CHLORIDE SOLUTION 0.9%, BOTOX 50 UNITÉS ALLERGAN, poudre pour solution injectable

Primary endpoint: Comparison of means of the Stony Brook Scar Evaluation Scale (SBSES) at 6 months (M6) (collected by a dermatology team assessor, blinded to randomization) for each scar half (treated with botulinum toxin injection or placebo).
Endpoint(s): Comparison of mean scores collected for each scar half (toxin-treated vs. placebo) by a dermatology team observer blinded to randomization at M3, M6, M12 and M18 for scar width (mm), Comparison of mean scores collected for each scar half (toxin-treated vs. placebo) by a dermatology team observer blinded to randomization at M3, M6, M12 and M18 for the Patient and Observer Scar Assessment Scale (POSAS): observer scale, Comparison of mean scores collected for each scar half (toxin-treated vs. placebo) by a dermatology team observer blinded to randomization at M3, M6, M12 and M18 for the Physician's Global Assesment., Comparison of mean scores collected for each scar half (toxin-treated vs. placebo) by a dermatology team observer blinded to randomization at M3, M12 and M18 for Stony Brook Scar Evaluation Scale

Source: https://euclinicaltrials.eu/ctis-public/view/2025-521290-14-00